EU clinical trial 2024-517968-36-00: C5751003 - AN OPEN-LABEL, RANDOMIZED, CONTROLLED PHASE 3 STUDY OF SIGVOTATUG VEDOTIN IN COMBINATION WITH PEMBROLIZUMAB COMPARED WITH PEMBROLIZUMAB MONOTHERAPY AS FIRST-LINE TREATMENT IN PARTICIPANTS WITH PD-L1 HIGH (≥50% OF TUMOR CELLS EXPRESSING PD-L1), LOCALLY ADVANCED, UNRESECTABLE, OR METASTATIC NON-SMALL CELL LUNG CANCER)
Protocol code: C5751003
Sponsor: Pfizer Inc. (Pharmaceutical company). Phase: Therapeutic confirmatory (Phase III). Countries: Hungary (authorised, recruiting), Poland (ongoing, recruiting), Spain (ongoing, recruiting), France (ongoing, recruiting), Greece (ongoing, recruiting), Germany (ongoing, recruiting), Italy (ongoing, recruiting), Bulgaria (ongoing, recruiting), Denmark (authorised, recruitment pending), Belgium (ongoing, recruiting), Slovakia (ongoing, recruiting), Czechia (ongoing, recruiting), Netherlands (ongoing, recruiting), Austria (ongoing, recruiting), Romania (ongoing, recruiting).
Therapeutic area(s): Diseases [C] - Neoplasms [C04]
Gender: Female, Male. Age: 18-64 years, 65+ years. Enrolment: 261.
Start date (EU): 2025-07-08. Decision date: 2025-06-17. Results received: No. Last updated: 2026-06-15.
Decision dates by country: DK: 2025-06-17, BE: 2025-06-18, DE: 2025-06-23, IT: 2025-06-19, NL: 2025-06-18, PL: 2025-06-24, AT: 2025-09-29, BG: 2025-06-20, GR: 2025-06-19, HU: 2025-06-23, SK: 2025-06-17, CZ: 2025-06-18, RO: 2025-09-29, FR: 2025-06-23, ES: 2025-06-19

Condition(s): non-small cell lung cancer
Product: KEYTRUDA 25 mg/mL concentrate for solution for infusion., Sigvotatug vedotin, KEYTRUDA 25 mg/mL concentrate for solution for infusion

Primary endpoint: OS, PFS using Response Evaluation Criteria in Solid Tumors, Version 1.1 (RECIST v1.1) as assessed by BICR
Endpoint(s): Confirmed ORR using RECIST v1.1 as assessed by BICR, PFS using RECIST v1.1 as assessed by investigator, Confirmed ORR using RECIST v1.1 as assessed by investigator, Duration of response (DOR) using RECIST v1.1 as assessed by BICR, DOR using RECIST v1.1 as assessed by investigator, Type, incidence, severity, seriousness, and relatedness of adverse events (AEs), Plasma concentration at end of infusion (CEOI) and Plasma predose concentration (Cpredose) for antibody conjugated monomethyl auristatin E (ac-MMAE) and unconjugated monomethyl auristatin E (MMAE), Incidence of antidrug antibodies (ADAs)

Source: https://euclinicaltrials.eu/ctis-public/view/2024-517968-36-00